EU clinical trial 2024-517419-62-00: (22752) A Phase 2 open-label basket study to evaluate the efficacy and safety of orally administered reversible tyrosine kinase inhibitor BAY 2927088 in participants with metastatic or unresectable solid tumors with HER2-activating mutations
Protocol code: 22752
Sponsor: Bayer Consumer Care AG, Bayer AG (Pharmaceutical company). Phase: Therapeutic exploratory (Phase II). Countries: Spain (ongoing, recruiting), Denmark (ongoing, recruiting), Italy (ongoing, recruiting), France (ongoing, recruiting).
Therapeutic area(s): Diseases [C] - Neoplasms [C04]
Gender: Female, Male. Age: 18-64 years, 65+ years. Enrolment: 37.
Status: Ongoing, recruiting. Start date (EU): 2025-02-28. Decision date: 2025-02-13. Results received: No. Last updated: 2026-03-12.
Decision dates by country: IT: 2025-02-18, DK: 2025-03-25, ES: 2025-02-13, FR: 2025-02-13

Condition(s): HER2 mutation, Advanced solid tumors
Product: BAY 2927088 Bayer (CM), BAY 2927088 Bayer (CM), BAY 2927088, BAY 2927088 Bayer

Primary endpoint: Objective response rate (ORR) per RECIST 1.1 as assessed by blinded independent central review (BICR)
Endpoint(s): Duration of response (DOR) per RECIST 1.1 as assessed by BICR, Time to response (TTR) per RECIST 1.1 as assessed by BICR, ORR per RECIST 1.1 as assessed by the investigator, Disease control rate (DCR) per RECIST 1.1 as assessed by BICR, DCR ≥12 weeks per RECIST 1.1 as assessed by BICR, Progression-free survival (PFS) per RECIST 1.1 as assessed by BICR, Disease control rate (DCR) per RECIST 1.1 as assessed by the investigator, DCR ≥12 weeks per RECIST 1.1 as assessed by the investigator, Progression-free survival (PFS) per RECIST 1.1 as assessed by the investigator, DOR per RECIST 1.1 as assessed by the investigator, TTR per RECIST 1.1 as assessed by the investigator, Overall survival (OS), Number of participants with treatment-emergent adverse events (TEAEs) and treatment-emergent serious adverse events (TESAEs) per CTCAE v 5.0, categorized by severity. Number of participants who discontinue study treatment due to an AE, Time to deterioration in EORTC QLQ-C30 physical functioning domain score, Change from baseline in EORTC QLQ-C30 physical functioning domain score, Change from baseline in EORTC QLQ-C30 global health status/quality of life (QoL)

Source: https://euclinicaltrials.eu/ctis-public/view/2024-517419-62-00